EU clinical trial 2022-501586-50-00: A Phase 3, Randomized, 52-week, Placebo-controlled, Double-blind Study With Rerandomization to Assess the Efficacy, Safety, and Tolerability of Rocatinlimab (AMG 451) in Adolescent Subjects With Moderate-to-severe Atopic Dermatitis (AD) (ROCKET-ASTRO)
Protocol code: 20210145
Sponsor: Amgen Inc. (Pharmaceutical company). Phase: Therapeutic confirmatory (Phase III). Countries: Croatia (ended), Italy (ended), Hungary (ended), Poland (ended), Romania (ended), Belgium (ended), Spain (ended), France (ended), Greece (ended), Germany (ended).
Therapeutic area(s): Diseases [C] - Immune System Diseases [C20]
Gender: Female, Male. Age: 0-17 years. Enrolment: 155.
Status: Ended. Start date (EU): 2023-05-15. End date (EU): 2025-07-28. End date: 2025-11-25. Decision date: 2023-04-19. Results received: Yes. Last updated: 2025-08-29.
Decision dates by country: FR: 2023-05-04, HR: 2023-04-24, RO: 2023-05-04, GR: 2023-05-04, ES: 2023-05-04, BE: 2023-05-04, HU: 2023-05-04, DE: 2023-05-04, IT: 2023-04-21, PL: 2023-04-24

Condition(s): Atopic Dermatitis

Primary endpoint: Achieving a pre-determined score at week 24, Achieving a pre-determined score at week 24
Endpoint(s): Achieving a pre-determined score, Achieving a pre-determiend score, Achieving a pre-determined score from baseline in weekly average of daily worst pruritus numeric rating scale (NRS) score in subjects with baseline weekly average of daily worst pruritus NRS score Achieving a pre-determined score from baseline in weekly average of daily worst pruritus NRS score at week 24 in subjects with baseline weekly average of daily worst pruritus NRS score, Achieving a pre-determined reduction from baseline in EASI at week 24, Achieving a pre-determined score from baseline in weekly average of AD skin pain NRS score at week 24 in subjects with baseline weekly average of AD skin pain NRS, Achieving a pre-determined score with presence of only barely perceptible erythema at week 24

Source: https://euclinicaltrials.eu/ctis-public/view/2022-501586-50-00